EU clinical trial 2024-519386-21-01: Pregnancy Outcomes: Effects of Metformin Study (POEM Study) a long term randomized controlled parallel group study in gestational diabetes mellitus
Sponsor: Bethesda Diabetes Research Center B.V. (Laboratory/Research/Testing facility). Phase: Therapeutic confirmatory (Phase III). Countries: Netherlands (ongoing, recruitment ended).
Therapeutic area(s): Not possible to specify
Gender: Female, Male. Age: 0-17 years, 18-64 years. Enrolment: 500.
Status: Ongoing, recruitment ended. Start date (EU): 2025-01-29. Decision date: 2025-01-29. Results received: No. Last updated: 2025-01-29.

Condition(s): Gestational diabetes mellitus
Product: Metformine HCl 850 mg Teva, filmomhulde tabletten

Primary endpoint: Phase A: GDM Outcome Score (= GOS), an ordinal variable (range 0-8) per pregnancy: (1) pregnancy related hypertension, including pre-eclampsia and eclampsia, (2) large for gestational age (LGA) at delivery (neonatal weight > 90th percentile), (3) premature delivery (< 37.0 weeks of gestation), (4) instrumental delivery, (5) caesarean delivery, (6) birth trauma, (7) neonatal hypoglycaemia (< 2.6 mmol/l), and (8) admission to the NICU., Phase B and Phase C have each three co-primary endpoints: maternal T2D, weight development in the mother, and weight development in the child.
Endpoint(s): Phase A: each of these eight endpoints apart is a secondary endpoint., MOS (maternal outcome score): including Caesarean delivery, Pre-eclampsia/eclampsia/HELLP syndrome/gestational hypertension, Maternal mortality, Postpartum haemorrhage, Thrombosis (in pregnancy and/or childbed)., NOS (neonatal outcome score): including Infant Respiratory Distress Syndrome (IRDS) needing nasal CPAP, optiflow, mechanical ventilation and/or surfactant replacement, stillbirth and neonatal death, preterm birth = birth before 37.0 weeks, dystocia of the shoulder during delivery, instrumental delivery, caesarean delivery, neonatal hypoglycaemia < 2.6 mmol/l, neonatal jaundice needing phototherapy, admission to NICU, Apgar score as a variable, Apgar score < 7 at 5 minutes, congenital anomaly, Maternal weight, weight gain and change in body compostition (impedance), Maternal glycaemic control: FPG and glucose tolerance, Maternale proteinuria, Maternal insulin rescue and daily dose of insulin after failure of study drug, Acceptability of treatment, Maternal urinary tract infection, Maternal metabolic varibales from venous sampling (please see protocol), Child: intra-uterine measurements by ultra-sonography, Child: foetal weight at delivery, Neonatal metabolic variables from umbilical cord, Phase B/C: Diabetes & Prediabetes development, Weight development, Hypertension development, thrombotic and CVD incidents, development of any chronic disease, Phase B/C: Growth and weight development, gonadal and gender development, puberty and maturation, eductional and intellectual development

Source: https://euclinicaltrials.eu/ctis-public/view/2024-519386-21-01